EU clinical trial 2023-510042-24-01: THE ALENDRONATE DISCONTINUATION STUDY
Sponsor: Odense University Hospital (Hospital/Clinic/Other health care facility). Phase: Therapeutic use (Phase IV). Countries: Denmark (ongoing, recruiting).
Therapeutic area(s): Diseases [C] - Musculoskeletal Diseases [C05]
Gender: Female. Age: 18-64 years, 65+ years. Enrolment: 1400.
Status: Ongoing, recruiting. Start date (EU): 2025-01-30. Decision date: 2024-07-22. Results received: No. Last updated: 2025-08-08.

Condition(s): osteoporosis
Product: TETRACYCLINE, ALENDRONIC ACID

Primary endpoint: Incidence of fragility fractures during the study periode
Endpoint(s): Changes in BMD spine and hip from inclusion to study end (3 years), Changes in Bone Turnover Markers over the study period (CTX and P1NP),Proportion of patients meeting restart criteria ,Adverse events.

Source: https://euclinicaltrials.eu/ctis-public/view/2023-510042-24-01